EU clinical trial 2024-515221-29-00: PRODIGE 51 - GASTFOX: Phase III randomised trial evaluating FOLFOX with or without DOCETAXEL (TFOX) as 1st line chemotherapy for locally advanced or metastatic oesophago-gastric adenocarcinoma
Protocol code: PRODIGE 51 - GASTFOX
Sponsor: Fondation Franc.Cancerologie Digestive (Hospital/Clinic/Other health care facility). Phase: Phase II and Phase III (Integrated). Countries: France (ended).
Therapeutic area(s): Diseases [C] - Neoplasms [C04]
Gender: Female, Male. Age: 18-64 years, 65+ years. Enrolment: 507.
Status: Ended. Start date (EU): 2016-12-19. End date (EU): 2025-02-27. Decision date: 2024-07-04. Results received: Yes. Last updated: 2024-07-04.

Condition(s): Locally advanced or metastatic oesogastric adenocarcinoma
Product: ANHYDROUS DOCETAXEL, FLUOROURACIL, FLUOROURACIL, OXALIPLATIN, CALCIUM LEVOFOLINATE

Primary endpoint: To assess the progression free survival at 12 months after the last randomisation
Endpoint(s): To assess the overall survival

Source: https://euclinicaltrials.eu/ctis-public/view/2024-515221-29-00